EU clinical trial 2023-508755-39-00: The GLORIA Study: A Phase 3, Randomized, Open-Label Study of the Anti-Globo H Vaccine Adagloxad Simolenin (OBI-822)/OBI-821 in the Adjuvant Treatment of Patients with High-Risk, Early-Stage Globo H-Positive Triple Negative Breast Cancer
Protocol code: OBI-822-011
Sponsor: Obi Pharma Inc. (Pharmaceutical company). Phase: Therapeutic confirmatory (Phase III). Countries: Poland (ended).
Therapeutic area(s): Diseases [C] - Neoplasms [C04]
Gender: Female, Male. Age: 18-64 years, 65+ years. Enrolment: 36.
Status: Ended. Start date (EU): 2022-05-16. End date (EU): 2025-04-23. End date: 2025-11-28. Decision date: 2024-08-09. Results received: Yes. Last updated: 2025-03-19.

Condition(s): Triple Negative Breast Cancer
Product: PEMBROLIZUMAB, Adagloxad simolenin with adjuvant, CAPECITABINE

Primary endpoint: IDFS (Invasive Disease Free Survival), defined by STEEP, as time from randomization to the date of first invasive disease recurrence (local, regional or distant), date of second primary invasive cancer (breast or not), or date of death from any cause, whichever occurs first.
Endpoint(s): 1. OS status., 2. Change from baseline in health-related quality of life (HRQOL) using the global health status/QoL scale from EORTC QLQ-C30 and EQ-5D-5L questionnaires., 3. Breast cancer-free interval (BCFI)., 4. Distant disease-free survival (DDFS)., 5. Incidence of AEs and SAEs, incidence of abnormal laboratory values, and change from baseline in safety parameters.

Source: https://euclinicaltrials.eu/ctis-public/view/2023-508755-39-00